EU clinical trial 2024-518154-16-00: RASolve 301: Phase 3 Multicenter, Open Label, Randomized Study of RMC-6236 versus Docetaxel in Patients with Previously Treated Locally Advanced or Metastatic RAS(MUT) NSCLC
Protocol code: RMC-6236-301
Sponsor: Revolution Medicines Inc. (Pharmaceutical company). Phase: Therapeutic confirmatory (Phase III). Countries: Poland (ongoing, recruiting), Belgium (ongoing, recruiting), Germany (ongoing, recruiting), Italy (ongoing, recruiting), Netherlands (ongoing, recruiting), Ireland (ongoing, recruiting), France (ongoing, recruiting), Spain (ongoing, recruiting).
Therapeutic area(s): Diseases [C] - Neoplasms [C04]
Gender: Female, Male. Age: 18-64 years, 65+ years. Enrolment: 354.
Status: Ongoing, recruiting. Start date (EU): 2025-08-27. Decision date: 2025-07-01. Results received: No. Last updated: 2026-07-27.
Decision dates by country: IE: 2025-07-04, ES: 2025-07-04, PL: 2025-07-07, BE: 2025-07-01, FR: 2025-07-04, DE: 2025-07-01, IT: 2025-08-04, NL: 2025-08-07

Condition(s): non-small cell lung cancer
Product: DOCETAXEL, DARAXONRASIB (RMC-6236), DARAXONRASIB (RMC-6236)

Primary endpoint: PFS is defined as time from randomization until disease progression or death from any cause, whichever occurs first. Progression is per RECIST v1.1 as assessed by Investigator. OS is defined as time from randomization until death from any cause.

Source: https://euclinicaltrials.eu/ctis-public/view/2024-518154-16-00